EU clinical trial 2022-500677-14-00: Optimization of Cyclosporin therapy in atopic dermatitis through multiomic predictive models of treatment response (DermAtOmics)
Protocol code: DermAtOmics
Sponsor: Fundación Para La Investigación Biomédica Del Hospital Universitario La Paz (Laboratory/Research/Testing facility). Phase: Therapeutic use (Phase IV). Countries: Spain (ongoing, recruitment ended).
Therapeutic area(s): Diseases [C] - Skin and Connective Tissue Diseases [C17]
Gender: Female, Male. Age: 0-17 years, 18-64 years, 65+ years. Enrolment: 100.
Status: Ongoing, recruitment ended. Start date (EU): 2022-09-28. Decision date: 2022-08-09. Results received: No. Last updated: 2022-08-09.

Condition(s): Adult, adolescent and paediatric patients with moderate-severe atopic dermatitis
Product: Capsorin 100 mg soft capsules, Capsorin 25 mg soft capsules, Capsorin 50 mg soft capsules

Primary endpoint: Percentage of patients with primary non-response to treatment with cyclosporine. Defined as fail to achieve EASI-75 (a 75% improvement in EASI score) at week 16 of follow-up.
Endpoint(s): Percentage of patients achieving EASI-75 at week 6 of follow-up., Percentage of patients reaching 90 percentage (EASI-90) improvement from baseline during follow-up., Time to treatment failure with cyclosporine defined as EASI ≤ 50 during follow-up after week 16., Mean percentage of change in EASI score from baseline to week 16., Percentage of change in SCORAD from baseline to the primary endpoint (week 16)., Percentage of patients experiencing an improvement of at least 75% in SCORAD from the baseline value., Reduction of IGA (investigator global assessment) at week 16., Time to IGA score of 0/1 (clear or almost clear)., Change of BSA (Body surface area) involment at week 16, Change in NRS (numerical rating scale) at week 16, Percentage of patients having a variation of 4 points in their improvement in DLQI (Dermatology Life Quality Index)., Change in POEM (Patient Oriented Eccema Measure) and DLQI (Dermatology Life Quality Index) at week 16., Change in the score of the different scales in the different follow-up visits compared to baseline visit., Rate of adverse events associated to CsA treatment.

Source: https://euclinicaltrials.eu/ctis-public/view/2022-500677-14-00